EU clinical trial 2024-519417-57-00: A randomized, double-masked, controlled, safety and tolerability study of VRDN-003 in participants with thyroid eye disease (TED)
Protocol code: VRDN-003-303
Sponsor: Viridian Therapeutics Inc. (Pharmaceutical company). Phase: Therapeutic confirmatory (Phase III). Countries: Spain (ongoing, recruitment ended), Poland (ongoing, recruitment ended), France (ongoing, recruitment ended), Germany (ongoing, recruitment ended).
Therapeutic area(s): Diseases [C] - Eye Diseases [C11]
Gender: Female, Male. Age: 18-64 years, 65+ years. Enrolment: 140.
Status: Ongoing, recruitment ended. Start date (EU): 2025-06-25. Decision date: 2025-06-05. Results received: No. Last updated: 2026-08-07.
Decision dates by country: PL: 2025-06-10, ES: 2025-06-12, FR: 2025-06-05, DE: 2025-06-11

Condition(s): Thyroid eye disease
Product: VRDN (Insulin-like growth factor-1 receptor [IGF-1R] inhibitor with half-life extension), TED SC Placebo

Primary endpoint: The primary study endpoint will assess the rate at which safety events occur after starting treatment with VRDN-003 (Treatment Emergent Adverse Event) through Week 24.
Endpoint(s): Changes in eye bulging at Week 24 versus measurements before the first dose., The rate at which safety events occur after starting treatment with VRDN-003 through study completion.

Source: https://euclinicaltrials.eu/ctis-public/view/2024-519417-57-00